EU clinical trial 2024-517463-23-00: Weight management with orismilast alone or in combination with s.c. semaglutide (WELOSITI)
Sponsor: Gentofte Hospital (Hospital/Clinic/Other health care facility). Phase: Therapeutic exploratory (Phase II). Countries: Denmark (authorised, recruitment pending).
Therapeutic area(s): Diseases [C] - Nutritional and Metabolic Diseases [C18]
Gender: Female, Male. Age: 18-64 years, 65+ years. Enrolment: 80.
Status: Authorised, recruitment pending. Decision date: 2025-01-21. Results received: No. Last updated: 2025-01-21.

Condition(s): obesity
Product: Orismilast, Orismilast, The placebo tablets are identical in contents to the orismilast IMP, apart from that they do not contain the pharmaceutically active molecule. The pharmaceutically active molecule is replaced by lactose, SEMAGLUTIDE

Primary endpoint: Percentage change in body weight from week 0 to week 16
Endpoint(s): Change in body weight in kilograms from week 0 to week 16, Body weight reduction ≥ 3% at week 16, Body weight reduction ≥ 5% at week 16, Body weight reduction ≥ 10% at week 16, change in high sensitivity CRP, change in IL-6, Change in TNF-alfa, Body weight reduction ≥ 15% at week 16, Change in BMI (kg/m2) from week 0 to 16, Change in waist-hip ratio from week 0, Change in waist circumference (cm) from week 0 to 16, Change in systolic and diastolic blood pressure (mmHg), Change in heart rate (beats per minute), Change in body composition (fat-free mass, total fat mass, visceral fat mass rating and bone mass) as measured by bioimpedance, Change in fasting serum/plasma concentrations of inflammatory biomarkers

Source: https://euclinicaltrials.eu/ctis-public/view/2024-517463-23-00